EU clinical trial 2022-502751-61-00: European Larynx Organ Preservation Study (ELOS): Induction chemotherapy with Docetaxel and Cisplatin (TP) followed by radiation compared to additional PD-1 inhibition in CPS ≥1 advanced laryngeal and hypopharyngeal cancer suitable for laryngectomy selected after short induction early response evaluation
Sponsor: University of Leipzig (Educational Institution). Phase: Therapeutic exploratory (Phase II). Countries: Germany (ongoing, recruiting).
Therapeutic area(s): Diseases [C] - Neoplasms [C04]
Gender: Female, Male. Age: 18-64 years, 65+ years. Enrolment: 140.
Status: Ongoing, recruiting. Start date (EU): 2024-04-10. Decision date: 2023-11-10. Results received: No. Last updated: 2025-12-18.

Condition(s): Advanced stage III, IVA, IVB laryngeal or II, III, IVA, IVB hypopharyngeal squamous cell carcinoma (SCC) curable by total laryngectomy. Note: PD-L1-expression within tumor tissue biopsy, calculated as CPS ≥ 1, is mandatory.
Product: CISPLATIN, KEYTRUDA 25 mg/mL concentrate for solution for infusion, DEXAMETHASONE, DOCETAXEL

Primary endpoint: 24-month to 48-month laryngectomy-free survival, the survival of the patient without laryngectomy, in the intent-to-treat population (flexible follow-up of the total cohort until 24 months after randomization of the last patient accrued). Laryngectomy or death from any cause count as event. Patients lost to follow-up will be censored at date of last visit with larynx at place.
Endpoint(s): 24-months to 48-months event-free survival (flexible follow-up), 24-months to 48-months overall survival (flexible follow-up), Quality of swallowing (QoS) assessed by FEES at time of randomization, 6 months and 24 months after IC-1

Source: https://euclinicaltrials.eu/ctis-public/view/2022-502751-61-00